EU clinical trial 2024-511076-32-00: A randomized, multicenter, open-label trial comparing the effectiveness of Inclisiran to bempedoic acid on LDL cholesterol (LDL-C) lowering in participants with atherosclerotic cardiovascular disease (VICTORION-CHALLENGE)
Protocol code: CKJX839A1DE02
Sponsor: Novartis Pharma GmbH (Pharmaceutical company). Phase: Therapeutic use (Phase IV). Countries: Germany (ended).
Therapeutic area(s): Diseases [C] - Cardiovascular Diseases [C14]
Gender: Female, Male. Age: 18-64 years, 65+ years. Enrolment: 400.
Status: Ended. Start date (EU): 2024-06-21. End date (EU): 2026-01-02. Decision date: 2024-05-28. Results received: No. Last updated: 2025-10-10.

Condition(s): Hypercholesterolemia
Product: INCLISIRAN SODIUM, BEMPEDOIC ACID, ATORVASTATIN, ROSUVASTATIN, EZETIMIBE

Primary endpoint: Percent change from baseline in LDL-C levels at day 150
Endpoint(s): Percent change from baseline in LDL-C levels at day 150, Individual responsiveness of participants defined through on treatment LDL-C levels of < 55 mg/dL (very high-risk subjects) and < 70 mg/dL (high risk subjects) at Day 150, Absolute change from Baseline in LDL-C at day 150, Percent change from baseline in LDL-C levels between Day 30 up to Day 150, Percent change from baseline in LDL-C levels between Day 90 and Day 150, Mean change from BL in MMAS-8 over time, Mean change from BL in TSQM over time, Mean change from BL in SF-BPI over time, Proportion of participants with clinically significant change from BL [MCID of 2 points] in SF-BPI at Day 150

Source: https://euclinicaltrials.eu/ctis-public/view/2024-511076-32-00